EU clinical trial 2023-507634-24-00: A Phase 3, Randomized, Double-Blind, Placebo-Controlled Trial: Multiple Independent Sub-studies of Setmelanotide in Patients with POMC/PCSK1, LEPR, NCOA1 (SRC1), or SH2B1 Gene Variants in the Melanocortin-4 Receptor Pathway
Protocol code: RM-493-035
Sponsor: Rhythm Pharmaceuticals Inc. (Pharmaceutical company). Phase: Therapeutic confirmatory (Phase III). Countries: France (ended), Germany (ended), Netherlands (ended), Greece (ended), Spain (ended).
Therapeutic area(s): Phenomena and Processes [G] - Digestive System and Oral Physiological Phenomena [G10]
Gender: Female, Male. Age: 0-17 years, 18-64 years. Enrolment: 85.
Status: Ended. Start date (EU): 2022-05-20. End date (EU): 2026-06-24. End date: 2026-06-30. Decision date: 2024-11-05. Results received: No. Last updated: 2025-11-28.
Decision dates by country: DE: 2024-11-05, GR: 2025-01-23, NL: 2024-11-25, FR: 2024-11-05, ES: 2024-11-07

Condition(s): Improper function of certain messenger materials in the body that control body weight and hunger in people
Product: Solution for Injection, subcutaneous Use, IMCIVREE 10 mg/ml solution for injection

Primary endpoint: The difference in mean change in body weight from baseline at 52 weeks in patients treated with setmelanotide compared to placebo, assessed as percent change from baseline body mass index (BMI)
Endpoint(s): The proportion of patients who achieve at least 5% reduction in baseline BMI at 52 weeks, in patients treated with setmelanotide compared to placebo, The difference in mean change in body weight from baseline at 52 weeks in adult patients (age ≥18 years at baseline) treated with setmelanotide compared to placebo, assessed as percent change in baseline body weight, The difference in mean percent change in the weekly average most hunger score at 52 weeks in patients treated with setmelanotide compared to placebo, utilizing the Hunger Questions for Patients ≥12 years of Age, The proportion of patients who achieve at least 10% reduction in baseline BMI at 52 weeks, in patients treated with setmelanotide compared to placebo, The difference in mean change in BMI from baseline at 52 weeks in pediatric patients (age <18 years at baseline) treated with setmelanotide compared to placebo assessed as change in baseline BMI Z-score, The difference in change from baseline at 52 weeks in % of the 95th BMI percentile, as defined by the Centers for Disease Control and Prevention (CDC), in patients <18 years at baseline treated with setmelanotide compared to placebo, The difference from baseline at 52 weeks in mean change in waist circumference in patients treated with setmelanotide compared to placebo, The overall safety and tolerability of setmelanotide in patients with genetic variants in the MC4R pathway • The difference in mean change from baseline at 52 weeks in physical functioning score and total score for Impact of Weight on Quality of Life in adults (IWQOL-Lite) and in children (IWQOL-Kids-Parent Proxy) in patients treated with setmelanotide compared to placebo, The difference in mean body weight loss, and % body weight loss at 52 weeks in setmelanotide responders (defined as patients with ≥5% body weight loss if ≥18 years of age, or a decrease in BMI by ≥3% if <18 years of age, after 0 weeks of therapy at 0 mg/day or at the maximally tolerated dose) as compared to the placebo group

Source: https://euclinicaltrials.eu/ctis-public/view/2023-507634-24-00